EU clinical trial 2024-516751-41-00: A Study to Assess the Effectiveness of Different Doses of GEH200486 Injection for Contrast-enhanced Head and Neck MRI in Healthy Volunteers
Protocol code: GE-227-202
Sponsor: GE Healthcare Limited (Pharmaceutical company). Phase: Human Pharmacology (Phase I)- Bioequivalence Study. Countries: Netherlands (ended).
Therapeutic area(s): Analytical, Diagnostic and Therapeutic Techniques and Equipment [E] - Diagnosis [E01]
Gender: Female, Male. Age: 18-64 years. Enrolment: 52.
Status: Ended. Start date (EU): 2024-11-08. End date (EU): 2025-05-07. Decision date: 2024-11-08. Results received: No. Last updated: 2024-11-22.

Condition(s): None - imaging technique

Source: https://euclinicaltrials.eu/ctis-public/view/2024-516751-41-00